EU clinical trial 2023-504104-29-00: An Open-label, Non-randomized, Phase 3 Study to Evaluate the Efficacy and Safety of Soticlestat in Participants With Dravet Syndrome or Lennox-Gastaut Syndrome Who Have Been Exposed to Fenfluramine.
Protocol code: TAK-935-3004
Sponsor: Takeda Development Center Americas Inc. (Pharmaceutical company). Phase: Therapeutic confirmatory (Phase III). Countries: Denmark (ended).
Therapeutic area(s): Diseases [C] - Nervous System Diseases [C10]
Gender: Female, Male. Age: 0-17 years, 18-64 years, 65+ years. Enrolment: 5.
Status: Ended. Start date (EU): 2024-04-15. End date (EU): 2024-08-14. End date: 2024-08-15. Decision date: 2023-11-14. Results received: Yes. Last updated: 2024-06-27.

Condition(s): Dravet Syndrome/Lennox-Gastaut Syndrome

Primary endpoint: Percent change from baseline in convulsive (DS) and MMD (LGS) seizure frequency per 28 days during the initial 12 weeks of the maintenance period.

Source: https://euclinicaltrials.eu/ctis-public/view/2023-504104-29-00